EU clinical trial 2024-512126-29-00: A Phase 3, Randomized, Double-Blind, Placebo-Controlled Study with an Open-label Extension Period to Evaluate the Efficacy and Safety of Telitacicept in Patients with Generalized Myasthenia Gravis
Protocol code: RC18G006
Sponsor: Vor Biopharma Inc. (Pharmaceutical company). Phase: Therapeutic confirmatory (Phase III). Countries: Italy (authorised, recruitment pending), Belgium (ongoing, recruiting), France (ongoing, recruiting), Spain (authorised, recruitment pending), Denmark (ended), Poland (authorised, recruiting), Czechia (ongoing, recruiting), Bulgaria (ongoing, recruiting).
Therapeutic area(s): Diseases [C] - Immune System Diseases [C20]
Gender: Female, Male. Age: 18-64 years, 65+ years. Enrolment: 107.
Start date (EU): 2025-02-25. Decision date: 2024-11-11. Results received: No. Last updated: 2026-05-28.
Decision dates by country: DK: 2024-11-12, BE: 2024-11-11, CZ: 2024-11-12, FR: 2024-11-18, IT: 2024-11-13, ES: 2024-11-11, PL: 2024-11-18, BG: 2026-05-28

Condition(s): Generalized Myasthenia Gravis
Product: Telitacicept injection, Placebo contains excipients only and is visually indistinguishable from the Telitacicept

Primary endpoint: Change from baseline in Myasthenia Gravis Activities of Daily Living (MG-ADL) score at Week 24
Endpoint(s): • Change from baseline in MG Quality of Life scale (MG-QOL15r) at Week 24, • Proportion of patients with a decrease of ≥2 points from baseline in MG-ADL score at Week 24, • Proportion of patients with a decrease of ≥3 points from baseline in QMG score at Week 24, • Proportion of patients who achieved minimal symptomatic expression (MSE, defined as having MG-ADL score of 0 or 1) at Week 24, Change from baseline in Quantitative Myasthenia Gravis (QMG) score at Week 24

Source: https://euclinicaltrials.eu/ctis-public/view/2024-512126-29-00